EU clinical trial 2024-511869-11-00: Efficacy of certolizumab in women with unexplained recurrent implantation failure: a double-blind randomized controlled trial (CERTIFY)
Protocol code: APHP200031
Sponsor: Assistance Publique Hopitaux De Paris (Hospital/Clinic/Other health care facility). Phase: Therapeutic confirmatory (Phase III). Countries: France (authorised, recruitment pending).
Therapeutic area(s): Diseases [C] - Immune System Diseases [C20]; Diseases [C] - Female Urogenital Diseases and Pregnancy Complications [C13]
Gender: Female. Age: 18-64 years. Enrolment: 161.
Status: Authorised, recruitment pending. Decision date: 2024-11-12. Results received: No. Last updated: 2025-07-25.

Condition(s): Adult women with recurrent implantation failures (RIF)
Product: Cimzia 200 mg solution for injection in pre-filled syringe, SODIUM CHLORIDE

Primary endpoint: Clinical pregnancy defined as the presence of cardiac activity on ultrasound scan at 5 weeks +/- 6 days of gestation (post-implantation)
Endpoint(s): Live-birth, Miscarriage defined as spontaneous abortion or pregnancy stop before 12 weeks of gestation (post-implantation), All adverse events distinguishing serious adverse events. We will particularly evaluate:, - multiple pregnancies, - ectopic pregnancy, - fetal abnormalities, - small for gestational age, - intrauterine growth restriction, - preeclampsia

Source: https://euclinicaltrials.eu/ctis-public/view/2024-511869-11-00